EU clinical trial 2024-512789-32-00: A Phase III study comparing the efficacy of the combination of doxorubicin and the tumor-targeting human antibody-cytokine fusion protein L19TNF to doxorubicin alone as first-line therapy in patients with advanced or metastatic soft tissue sarcoma
Protocol code: PH-L19TNFDOX2-03/16
Sponsor: Philogen S.p.A. (Pharmaceutical company). Phase: Therapeutic confirmatory (Phase III). Countries: Spain (ongoing, recruitment ended), France (ongoing, recruitment ended), Germany (ongoing, recruitment ended), Poland (ongoing, recruitment ended), Italy (ongoing, recruitment ended).
Therapeutic area(s): Diseases [C] - Neoplasms [C04]
Gender: Female, Male. Age: 18-64 years, 65+ years. Enrolment: 118.
Status: Ongoing, recruitment ended. Start date (EU): 2017-10-09. Decision date: 2024-05-03. Results received: No. Last updated: 2026-06-12.
Decision dates by country: PL: 2024-05-06, DE: 2024-05-03, FR: 2024-05-06, IT: 2024-05-07, ES: 2024-05-07

Condition(s): Unresectable or metastatic soft tissue sarcoma
Product: Fibromun, Doxorubicin 2 mg/ml Solution for Injection.

Primary endpoint: The following efficacy endpoint will be considered: − Progression-free survival (PFS)
Endpoint(s): To assess the safety profile of L19TNF combined with doxorubicin. The following safety endpoints will be considered: − Adverse Events (AEs) assessment based on CTCAE v.4.03. − Standard laboratory (haematology, biochemistry and urinalysis) parameters. − Physical examination findings including assessment of vital signs and physical measurements.

Source: https://euclinicaltrials.eu/ctis-public/view/2024-512789-32-00